EU clinical trial 2023-503469-49-00: A Randomized, Open-label, Phase 3 study of the Combination of Ibrutinib plus Venetoclax versus Chlorambucil plus Obinutuzumab for the First-line Treatment of Subjects with Chronic Lymphocytic Leukemia (CLL)/Small Lymphocytic Lymphoma (SLL)
Protocol code: 54179060CLL3011
Sponsor: Janssen - Cilag International (Pharmaceutical company). Phase: Therapeutic confirmatory (Phase III). Countries: Netherlands (ongoing, recruitment ended), Spain (ongoing, recruitment ended), Czechia (ongoing, recruitment ended), Sweden (ended), France (ongoing, recruitment ended), Belgium (ongoing, recruitment ended), Denmark (ongoing, recruitment ended), Poland (ongoing, recruitment ended).
Therapeutic area(s): Diseases [C] - Neoplasms [C04]
Gender: Female, Male. Age: 18-64 years, 65+ years. Enrolment: 100.
Start date (EU): 2018-04-19. Decision date: 2023-10-19. Results received: No. Last updated: 2026-02-24.
Decision dates by country: SE: 2023-10-23, BE: 2023-10-23, NL: 2023-10-19, CZ: 2023-10-25, DK: 2023-11-08, FR: 2023-10-20, ES: 2023-10-24, PL: 2023-11-17

Condition(s): Chronic Lymphocytic Leukemia (CLL), Small Lymphocytic Lymphoma (SLL)
Product: Ibrutinib - capsule - 140 mg

Primary endpoint: Progression-free survival (PFS) as assessed by an Independent Review Committee (IRC)

Source: https://euclinicaltrials.eu/ctis-public/view/2023-503469-49-00